EU clinical trial 2024-515605-26-00: Bioequivalence study of two sulodexide preparations: Sulodexide Intexo 250 LRU and Vessel Due F 250 LRU cps
Protocol code: SDX-CVU-FAST-001-24
Sponsor: Intexo Societa Benefit S.r.l. (Pharmaceutical company). Phase: Human Pharmacology (Phase I)- Bioequivalence Study. Countries: Portugal (authorised, recruitment pending).
Therapeutic area(s): Not possible to specify
Gender: Female, Male. Age: 18-64 years. Enrolment: 20.
Status: Authorised, recruitment pending. Decision date: 2024-09-19. Results received: No. Last updated: 2024-09-19.

Condition(s): No medical condition.

Source: https://euclinicaltrials.eu/ctis-public/view/2024-515605-26-00